EU clinical trial 2023-506163-34-00: Efficacy and safety of the proposed biosimilar PERT-IJS versus EU-Perjeta® along with trastuzumab and chemotherapy (carboplatin and docetaxel) as neoadjuvant treatment in chemotherapy naïve patients with early stage or locally advanced HR negative and HER2 positive breast cancer
Protocol code: BIO-PERTUZ-301
Sponsor: Biocon Biologics UK Limited (Pharmaceutical company). Phase: Therapeutic confirmatory (Phase III). Countries: Poland (ended), Romania (ended).
Therapeutic area(s): Diseases [C] - Immune System Diseases [C20]
Gender: Female. Age: 18-64 years, 65+ years. Enrolment: 46.
Status: Ended. End date (EU): 2025-02-24. Decision date: 2023-11-22. Results received: No. Last updated: 2023-11-27.
Decision dates by country: RO: 2023-11-27, PL: 2023-11-22

Condition(s): Hormone Receptor Negative (HR-ve) Human Epidermal Growth Factor Receptor 2 (HER2)-positive Early Stage or Locally Advanced Breast Cancer

Source: https://euclinicaltrials.eu/ctis-public/view/2023-506163-34-00